EU clinical trial 2025-523931-21-00: Trial to Evaluate the Safety and Preliminary Efficacy of GEN1079 in Participants with Advanced Solid Tumors
Protocol code: GCT1079-01
Sponsor: Genmab A/S (Pharmaceutical company). Phase: Human Pharmacology (Phase I)- First administration to humans. Countries: Spain (ongoing, recruiting).
Therapeutic area(s): Diseases [C] - Neoplasms [C04]
Gender: Female, Male. Age: 18-64 years, 65+ years. Enrolment: 77.
Status: Ongoing, recruiting. Start date (EU): 2026-04-07. Decision date: 2026-03-24. Results received: No. Last updated: 2026-07-22.

Condition(s): Advanced Malignant Solid Tumors

Source: https://euclinicaltrials.eu/ctis-public/view/2025-523931-21-00